EU clinical trial 2025-522169-31-00: AcSé HER2_Widening treatment options among adult patients with HER2-overexpressing or mutant solid cancers
Protocol code: UC-GMP-2505
Sponsor: Unicancer (Hospital/Clinic/Other health care facility). Phase: Therapeutic exploratory (Phase II). Countries: France (ongoing, recruiting).
Therapeutic area(s): Diseases [C] - Neoplasms [C04]
Gender: Female, Male. Age: 18-64 years, 65+ years. Enrolment: 105.
Status: Ongoing, recruiting. Start date (EU): 2025-10-30. Decision date: 2025-10-01. Results received: No. Last updated: 2025-10-01.

Condition(s): Adult Patients with HER2-IHC3+ selected solid cancers (endometrial, colorectal, head & neck or sarcoma) or HER2 mutant non-small cell lung cancer.
Product: JZP598

Primary endpoint: Confirmed Objective Response Rate (ORR) for each cohort, based on best overall response, defined as the percentage of patients with a complete response (CR) or partial response (PR) during treatment or follow-up, assessed according to RECIST1.1, by investigator assessment and confirmed by a follow-up scan at ≥ 4 weeks from first response assessment.
Endpoint(s): Confirmed ORR for each cohort, based on best overall response as adjudicated by the BICR, defined as the percentage of patients with a CR or PR during treatment or follow-up, assessed according to RECIST1.1 and confirmed by a follow-up scan at ≥ 4 weeks from first response assessment ., Duration of Response (DoR) for each cohort will be evaluated in patients with either a CR or PR. DoR is defined as the time from the first assessment of a confirmed CR or PR until the date of the first occurrence of progressive disease (PD) according to RECIST1.1 or death from any cause (if death occurs within predefined period), whichever occurs first. At the time of analysis, a patient alive and without disease progression will be censored at the date of the last valid tumor assessment., Progression Free Survival (PFS) for each cohort is defined as the time from study registration until disease progression (per RECIST1.1) or death from any cause, whichever occurs first. At the time of analysis, a patient alive and without disease progression will be censored at the date of the last valid tumor assessment. PFS will be provided as assessed by investigators and as adjudicated by the BICR., Clinical Benefit Rate (CBR) for each cohort is defined as the percentage of patients with a CR or PR or stable disease (SD) for more than 16 weeks from inclusion assessed according to RECIST1.1. CBR will be provided as assessed by investigators and as adjudicated by the BICR., Overall Survival (OS) for each cohort is defined as the time from study registration until death from any cause. Patients who are alive at last follow-up will be censored at this date., The safety will be evaluated according to the incidence of adverse events (AEs) graded by NCI-CTCAE v5.0, per cohort and overall.

Source: https://euclinicaltrials.eu/ctis-public/view/2025-522169-31-00